EU clinical trial 2024-517988-23-00: C6081001: A Phase 1 Study of PF-07985045 in Participants with Advanced Solid Tumors
Protocol code: C6081001
Sponsor: Pfizer Inc. (Pharmaceutical company). Phase: Human Pharmacology (Phase I)- First administration to humans. Countries: France (ended), Spain (ended).
Therapeutic area(s): Diseases [C] - Neoplasms [C04]
Gender: Female, Male. Age: 18-64 years, 65+ years. Enrolment: 61.
Status: Ended. End date (EU): 2026-01-07. End date: 2026-05-12. Decision date: 2025-06-19. Results received: No. Last updated: 2025-06-23.
Decision dates by country: FR: 2025-06-19, ES: 2025-06-23

Condition(s): KRAS mutated advanced solid tumors

Source: https://euclinicaltrials.eu/ctis-public/view/2024-517988-23-00